EU clinical trial 2024-510800-35-00: A Phase 3, Two-Stage, Randomized, Multicenter, Open-label Study Comparing Iberdomide, Daratumumab and Dexamethasone (IberDd) versus Daratumumab, Bortezomib, and Dexamethasone (DVd) in Subjects with Relapsed or Refractory Multiple Myeloma (RRMM) (EXCALIBER-RRMM)
Protocol code: CC-220-MM-002
Sponsor: Celgene Corp. (Pharmaceutical company). Phase: Therapeutic confirmatory (Phase III). Countries: Germany (ongoing, recruitment ended), Greece (ongoing, recruitment ended), Spain (ongoing, recruitment ended), France (ongoing, recruitment ended), Norway (ongoing, recruitment ended), Ireland (ongoing, recruitment ended), Portugal (ongoing, recruitment ended), Austria (ongoing, recruitment ended), Finland (ongoing, recruitment ended), Netherlands (ongoing, recruitment ended), Belgium (ongoing, recruitment ended), Italy (ongoing, recruitment ended), Sweden (ended), Poland (ongoing, recruitment ended), Czechia (ongoing, recruitment ended), Denmark (ongoing, recruitment ended).
Therapeutic area(s): Diseases [C] - Neoplasms [C04]
Gender: Female, Male. Age: 18-64 years, 65+ years. Enrolment: 394.
Start date (EU): 2022-06-17. Decision date: 2024-07-30. Results received: No. Last updated: 2026-04-27.
Decision dates by country: SE: 2024-09-20, NO: 2024-09-20, CZ: 2024-09-20, PL: 2024-09-20, FR: 2024-09-20, GR: 2024-07-30, PT: 2024-09-20, DK: 2024-09-20, DE: 2024-07-31, AT: 2024-09-20, ES: 2024-07-31, IE: 2024-09-20, NL: 2024-09-20, FI: 2024-09-20, BE: 2024-09-20, IT: 2024-09-20

Condition(s): Relapsed or Refractory Multiple Myeloma (RRMM)
Product: Iberdomide, Iberdomide, Dexamethasone 2mg Tablets , BORTEZOMIB, DARZALEX 1800 mg solution for injection, Dexamethason-ratiopharm® 4 mg Tabletten, Iberdomide, Iberdomide

Primary endpoint: Progression-free survival (PFS): Time from randomization to the first documentation of progressive disease according to the International Myeloma Working Group (IMWG) Uniform Response Criteria for Multiple Myeloma 2016 or death due to any cause, whichever occurs first., Minimal Residual Disease (MRD) negative CR at any time: Achievement of MRD negativity defined as less than 1 in 10^5 nucleated cells (by next generation flow cytometry) in bone marrow aspirate for subjects who achieve CR or better at any time after randomization
Endpoint(s): Recommended iberdomide dose for Stage 2, based on the totality of safety, efficacy, PK and PD data; In Stage 1, PK of iberdomide; Overall survival, Sustainability of MRD negativity; Overall response; Time to response; Duration of response; Time to progression; Time to next treatment; Progression-free survival 2; Safety; EORTC QLQ-C30 and EORTC QLQ-MY20

Source: https://euclinicaltrials.eu/ctis-public/view/2024-510800-35-00